EU clinical trial 2023-506517-22-00: A Phase 1b/2, Open-Label Study of Amivantamab Monotherapy and in Addition to Standard-of-Care Chemotherapy in Participants with Advanced or Metastatic Colorectal Cancer
Protocol code: 61186372GIC2002
Sponsor: Janssen - Cilag International (Pharmaceutical company). Phase: Phase I and Phase II (Integrated)- Other. Countries: Belgium (ongoing, recruiting), Spain (ongoing, recruiting), Italy (ongoing, recruiting), Germany (ongoing, recruiting).
Therapeutic area(s): Diseases [C] - Neoplasms [C04]
Gender: Female, Male. Age: 18-64 years, 65+ years. Enrolment: 37.
Status: Ongoing, recruiting. Start date (EU): 2022-08-31. Decision date: 2024-01-02. Results received: No. Last updated: 2026-02-16.
Decision dates by country: BE: 2024-01-08, IT: 2024-01-08, ES: 2024-01-02, DE: 2024-01-08

Condition(s): Advanced or Metastatic Colorectal Cancer
Product: Irinotecan Hikma 20 mg/ml Konzentrat zur Herstellung einer Infusionslösung, Oxaliplatin Hikma 5 mg/ml Konzentrat zur Herstellung einer Infusionslösung, FLUOROURACIL, IRINOTECAN, Fluorouracil Hikma 50 mg/ml Injektionslösung, Ribofolin® 10 mg/ml Injektionslösung, JNJ-61186372, OXALIPLATIN, CALCIUM FOLINATE, JNJ-61186372, BENDAFOLIN 10 mg/ml Injektionslösung, 5-FU medac 50 mg/ml, Injektionslösung

Primary endpoint: Objective response rate (ORR)

Source: https://euclinicaltrials.eu/ctis-public/view/2023-506517-22-00